EU clinical trial 2024-519790-19-00: IMMUNOTHERAPY WITH DIFFERENTIATED T CELLS, ADULTS, AUTOLOGOUS, FROM PERIPHERAL BLOOD, SELECTED BY CD62L EXPRESSION, EXPANDED AND TRANSDUCED (GENETICALLY MODIFIED) THROUGH A LENTIVIRAL VECTOR TO EXPRESS A CHIMERIC RECEPTOR WITH ANTI-CD19 SPECIFICITY ASSOCIATED WITH CO-STIMULATORY SEQUENCES 4-1-BB AND CD3Ζ IN PATIENTS WITH B-CELL NON-HODGKIN LYMPHOMA.
Sponsor: Fundacio Institut De Recerca De L'Hospital De La Santa Creu I Sant Pau (Hospital/Clinic/Other health care facility). Phase: Phase I and Phase II (Integrated)- First administration to humans. Countries: Spain (ongoing, recruiting).
Therapeutic area(s): Diseases [C] - Hemic and Lymphatic Diseases [C15]; Analytical, Diagnostic and Therapeutic Techniques and Equipment [E] - Therapeutics [E02]
Gender: Female, Male. Age: 18-64 years, 65+ years. Enrolment: 40.
Status: Ongoing, recruiting. Start date (EU): 2025-01-24. Decision date: 2025-01-24. Results received: No. Last updated: 2025-09-29.

Condition(s): Relapsed/refractory large B-cell non-Hodgkin lymphoma, mantle cell lymphoma, and follicular lymphoma
Product: Levact 2,5 mg/ml, polvo para concentrado para solución para perfusión., Beneflur10 mg comprimidos recubiertos con película, RoActemra 20 mg/mL concentrate for solution for infusion, Genoxal 200 mg polvo para solución inyectable y para perfusión, HSP-CAR19M

Primary endpoint: Safety associated with the infusion of HSP-CAR19M cells. In the expansion phase: evaluation of the safety and efficacy of HSP-CAR19M cell administration.

Source: https://euclinicaltrials.eu/ctis-public/view/2024-519790-19-00